EU clinical trial 2024-516410-38-00: PDH-RAVICTI - A PHASE II, MULTICENTRIC, PROSPECTIVE, NON-COMPARATIVE CLINICAL TRIAL TO ASSESS THE EFFICACY AND SAFETY OF THE TREATMENT OF PYRUVATE DEHYDROGENASE DEFICIENCY (PDH) PATIENTS WITH GLYCEROL PHENYLBUTYRATE (RAVICTI®)
Protocol code: APHP230834
Sponsor: Assistance Publique Hopitaux De Paris (Hospital/Clinic/Other health care facility). Phase: Therapeutic exploratory (Phase II). Countries: France (ongoing, recruiting).
Therapeutic area(s): Diseases [C] - Nutritional and Metabolic Diseases [C18]; Diseases [C] - Nervous System Diseases [C10]
Gender: Female, Male. Age: 0-17 years, 18-64 years. Enrolment: 15.
Status: Ongoing, recruiting. Start date (EU): 2025-10-01. Decision date: 2025-04-22. Results received: No. Last updated: 2026-04-07.

Condition(s): Pyruvate dehydrogenase deficiency
Product: RAVICTI 1.1 g/ml oral liquid

Primary endpoint: The efficacy of Glycerol Phenylbutyrate treatment on fatigue at 6 months will be evaluated by the Pediatric Quality of Life Inventory™ Multidimensional Fatigue Scale (PedsQL™ MFS, appendix 4 to 6). Difference between the total score at M0 and M6 will be calculated. Improving the overall score of 20% between M0 and M6 will reflect the impact of treatment on fatigue (success of the treatment).

Source: https://euclinicaltrials.eu/ctis-public/view/2024-516410-38-00